EU clinical trial 2024-517793-25-00: A phase I study investigating the local tolerability and pharmacokinetics of isoniazid (INH) inhalation by wet nebulization in patients with tuberculosis
Sponsor: Universitair Medisch Centrum Groningen (Hospital/Clinic/Other health care facility). Phase: Human Pharmacology (Phase I)- First administration to humans. Countries: Netherlands (ongoing, recruiting).
Therapeutic area(s): Diseases [C] - Bacterial Infections and Mycoses [C01]
Gender: Female, Male. Age: 18-64 years, 65+ years. Enrolment: 8.
Status: Ongoing, recruiting. Start date (EU): 2026-03-30. Decision date: 2024-11-29. Results received: No. Last updated: 2024-11-29.

Condition(s): Tuberculosis

Source: https://euclinicaltrials.eu/ctis-public/view/2024-517793-25-00